EU clinical trial 2023-510006-40-00: A Randomized, Double-Blind, Multicenter, Placebo-Controlled Phase 3 Study with Open-Label Period to Evaluate the Efficacy and Safety of Inebilizumab in Adults with Myasthenia Gravis [VIB0551.P3.S1 MINT]
Protocol code: VIB0551.P3.S1
Sponsor: Horizon Therapeutics Ireland Designated Activity Company (Pharmaceutical company). Phase: Therapeutic confirmatory (Phase III). Countries: Spain (ended), Germany (ended), France (ongoing, recruitment ended), Poland (ongoing, recruitment ended), Italy (ongoing, recruitment ended).
Therapeutic area(s): Diseases [C] - Immune System Diseases [C20]
Gender: Female, Male. Age: 18-64 years, 65+ years. Enrolment: 125.
Start date (EU): 2021-03-22. Decision date: 2024-05-07. Results received: No. Last updated: 2026-05-13.
Decision dates by country: DE: 2024-05-10, FR: 2024-05-14, ES: 2024-05-09, IT: 2024-05-20, PL: 2024-05-07

Condition(s): Myasthenia Gravis which is either due to acetylcholine receptor antibodies (AChR) or muscle specific kinase antibodies (MuSK).
Product: INEBILIZUMAB, 10 mL (nominal) solution containing 10 mM histidine/histidine hydrochloride, 75 mM sodium chloride, 106 mM (4% [w/v]) trehalose dihydrate, and 0.02% (w/v) polysorbate 80, pH 6.0

Primary endpoint: Change from baseline in Myasthenia Gravis Activities of Daily Living (MG-ADL) score at Week 26 in the overall study population (ie, the AChR-Ab+ and MuSK-Ab+ populations).
Endpoint(s): 1 (Key). Change from baseline in Quantitative Myasthenia Gravis (QMG) score at Week 26 in the overall study population, 2 (Key). Change from baseline in MG-ADL score at Week 26 in the AChR-Ab+ population., 3 (Key). Change from baseline in QMG score at Week 26 in the AChR-Ab+ population, 4 (Key). Change from baseline in MG-ADL score at Week 26 in the MuSK-Ab+ population., 5 (Key). Change from baseline in QMG score at Week 26 in the MuSK-Ab+ population, 1 (Additional). The proportion of subjects with ≥ 3-point improvement in MG-ADL score at Week 26 and no use of rescue therapy between Day 28 and Week 26 in the overall study population, the AChR-Ab+ population, and the MuSK-Ab+ population and at Week 52 and no use of rescue therapy between Day 28 and Week 52 in the AChR-Ab+ population., 2 (Additional). Change from baseline in MG-ADL score at Week 52 in the AChR-Ab+ population., 3 (Additional). Change from baseline in QMG score at Week 52 in the AChR-Ab+ population, 4 (Additional). Change from baseline in Myasthenia Gravis Composite (MGC) score at Week 26 in the overall study population, the AChR-Ab+ population, and the MuSK-Ab+ population and at Week 52 in the AChR-Ab+ population., 5 (Additional). Change from baseline in Myasthenia Gravis Quality of Life-15, revised score at Week 26 in the overall study population, the AChR-Ab+ population, and the MuSK-Ab+ population and at Week 52 in the AChR-Ab+ population, 6 (Additional). Patient Global Impression of Change score at Week 26 in the overall study population, the AChR-Ab+ population, and the MuSK-Ab+ population and at Week 52 in the AChR-Ab+ population., 7 (Additional). Time to first MG exacerbation by Week 26 in the overall study population, the AChR-Ab+ population, and the MuSK-Ab+ population and by Week 52 in the AChR-Ab+ population., 8 (Additional). The safety and tolerability of inebilizumab as measured by the incidence of treatment-emergent adverse events, adverse events of special interest, and treatment-emergent serious adverse events. Laboratory measurements will also be evaluated as part of safety, 9 (Additional). The proportion of subjects with steroid tapered to ≤ 5 mg/day at Week 26 for the overall study population, the AChR-Ab+ population, and the MuSK-Ab+ population and at Week 52 for the AChR-Ab+ population., 10 (Additional). The proportion of subjects in whom steroid dose was reduced by ≥ 50% by Week 26 for the overall study population, the AChR-Ab+ population, and the MuSK-Ab+ population and by Week 52 for the AChR-Ab+ population., 11 (Additional). The proportion of subjects achieving minimal symptom expression, defined as MG-ADL = 0 or 1, at Week 26., 12 (Additional). Anti-drug antibody status and titer during the study in the overall study population, the AChR-Ab+ population, and the MuSK-Ab+ population.

Source: https://euclinicaltrials.eu/ctis-public/view/2023-510006-40-00